EU clinical trial 2023-507682-25-00: (21683) Phase 2b open-label clinical study to evaluate the tolerability and safety of an initiation dose of 5 mg of Vericiguat in participants with chronic heart failure with reduced ejection fraction
Protocol code: 21683 "VELOCITY"
Sponsor: Bayer AG (Pharmaceutical company). Phase: Therapeutic exploratory (Phase II). Countries: Spain (ended), Italy (ended), Sweden (ended), Hungary (ended), Poland (ended).
Therapeutic area(s): Diseases [C] - Cardiovascular Diseases [C14]
Gender: Female, Male. Age: 18-64 years, 65+ years. Enrolment: 111.
Status: Ended. Start date (EU): 2024-05-13. End date (EU): 2024-07-29. End date: 2024-07-30. Decision date: 2024-05-08. Results received: Yes. Last updated: 2024-07-17.
Decision dates by country: PL: 2024-05-13, SE: 2024-05-08, ES: 2024-05-10, IT: 2024-05-09, HU: 2024-05-08

Condition(s): Chronic heart failure with reduced ejection fraction
Product: BAY 1021189

Primary endpoint: Treatment tolerability, defined as the completion of the two-week 5 mg dose without discontinuation of study intervention, Treatment tolerability, defined as the completion of the two-week 5 mg dose without moderate to severe symptomatic hypotension between Visit 1 and Visit 2
Endpoint(s): Any AE reported between Visit 1 and 2, Absence of AE related to study intervention between Visit 1 and Visit 2., Continuous intake of study intervention between Visit 1 and Visit 2 or restart of study intervention after any temporary interruption.

Source: https://euclinicaltrials.eu/ctis-public/view/2023-507682-25-00